EU clinical trial 2024-513075-40-00: A phase 2 study of Belantamab Mafodotin in patients with relapsed or refractory AL amyloidosis
Protocol code: EMN27
Sponsor: European Myeloma Network B.V., Emn Trial Office S.r.l. Impresa Sociale (Patient organisation/association, Laboratory/Research/Testing facility). Phase: Therapeutic exploratory (Phase II). Countries: Netherlands (ended), Germany (ended), Greece (ended), France (ended), Italy (ended).
Therapeutic area(s): Diseases [C] - Immune System Diseases [C20]
Gender: Female, Male. Age: 18-64 years, 65+ years. Enrolment: 33.
Status: Ended. Start date (EU): 2021-03-01. End date (EU): 2025-07-17. End date: 2025-07-17. Decision date: 2024-08-22. Results received: Yes. Last updated: 2025-05-09.
Decision dates by country: DE: 2024-08-26, GR: 2024-08-22, IT: 2024-09-10, NL: 2024-08-22, FR: 2024-08-22

Condition(s): Relapsed or refractory AL amyloidosis

Primary endpoint: The primary end point of the trial is the CR/VGPR/low-dFLC response rate at 6 months/ 4 cycles from start of therapy with blmf, according to consensus response criteria
Endpoint(s): Evaluation of safety (grade 3 or higher adverse events rates related to blmf therapy, treatment discontinuation rates, any grade hematologic adverse events, any grade non-hematologic adverse events), The limitation in the number of characters in this section does not allow to enter the endpoint. Please refer to the trial protocol, Derived PK parameter values for belantamab mafodotin as data permit

Source: https://euclinicaltrials.eu/ctis-public/view/2024-513075-40-00